EU clinical trial 2023-504014-30-00: A phase IV, randomized double blinded placebo-controlled study on the barrier restoring capacity of Dupilumab in type 2 airway disease: CRSwNP
Sponsor: UZ Leuven (Hospital/Clinic/Other health care facility). Phase: Therapeutic use (Phase IV). Countries: Belgium (ended).
Therapeutic area(s): Diseases [C] - Otorhinolaryngologic Diseases [C09]
Gender: Female, Male. Age: 18-64 years, 65+ years. Enrolment: 44.
Status: Ended. Start date (EU): 2023-11-14. End date (EU): 2025-09-16. Decision date: 2023-06-23. Results received: No. Last updated: 2023-08-28.

Condition(s): chronic rhinosinusitis with nasal polyps
Product: Placebo matching to dupilumab, Dupixent 300 mg solution for injection in pre-filled syringe

Primary endpoint: Change in tight junction expression (Occludin, ZO -1, -2, -3 claudin-1, -4, -7) between baseline, 12 weeks and 24 weeks of add-on treatment evaluated with RTq-PCR and with immunohistochemistry (IHC), Look at the change in mucosal explant integrity between baseline, 12 weeks, and 24 weeks of add on treatment with Dupilumab by means of Ussing Chambers., Change in gene expression profiling between baseline, 12 weeks and 24 weeks of add on treatment with Dupilumab by bulk RNA sequencing.
Endpoint(s): Change in inflammatory markers in blood: IgE, blood eosinophils, ECP, IL-4, IL-5, IL-13 between baseline 12 weeks and 24 weeks of add on treatment with Dupilumab, Change in markers of remodelling in serum: MMP-9, MMP-12, CC-16 between baseline, 12 weeks, and 24 weeks of add on treatment with Dupilumab., Evolution of the following patient reported outcomes (PROs) between baseline and 24 weeks of add on treatment with Dupilumab and the follow up visit. o Visual analogue scale (VAS) o Sino-nasal outcome test-22 (SNOT-22) o University of Pennsylvania smell identification test (UPSIT) o Asthma quality of life questionnaire (AQLQ) o Asthma control questionnaires 6-item version (ACQ-6) o Patients’ global impression of change (PGI-Change), Change in FeNo levels between baseline, 12 weeks, and 24 weeks of add on treatment with Dupilumab., Change in IOS measurements between baseline, 12 weeks, and 24 weeks of add on treatment with Dupilumab, Change in histamine challenge test between baseline, 12 weeks, and 24 weeks of add on treatment with Dupilumab., Change in NP score between baseline, 12 weeks and 24 weeks of add on treatment with Dupilumab.

Source: https://euclinicaltrials.eu/ctis-public/view/2023-504014-30-00